EU clinical trial 2024-510977-27-00: A Master Protocol of an Open-Label, Multi-Drug, Multi-Centre, Phase II Study to Evaluate the Efficacy, Safety, Tolerability, Pharmacokinetics, and Immunogenicity of Novel Combinations in Participants with Locally Advanced Unresectable or Metastatic Gastric or Gastroesophageal Junction Adenocarcinoma.
Protocol code: D7986C00001
Sponsor: AstraZeneca AB (Pharmaceutical company). Phase: Therapeutic exploratory (Phase II). Countries: Spain (ongoing, recruiting).
Therapeutic area(s): Diseases [C] - Neoplasms [C04]
Gender: Female, Male. Age: 18-64 years, 65+ years. Enrolment: 8.
Status: Ongoing, recruiting. Start date (EU): 2023-04-14. Decision date: 2024-04-04. Results received: No. Last updated: 2026-06-09.

Condition(s): Locally Advanced Unresectable or Metastatic Gastric or Gastroesophageal Junction Adenocarcinoma
Product: Rilvegostomig, AZD0901, CAPECITABINE, OXALIPLATIN, CAPECITABINE, AZD7789, CALCIUM FOLINATE, FLUOROURACIL, volrustomig

Primary endpoint: ORR in response evaluable set, PFS6 in full analysis set
Endpoint(s): DoR per RECIST 1.1 based on Investigator assessment., PFS per RECIST 1.1 as assessed by the Investigator., OS., Incidence of AEs, AESIs, and SAEs; physical examination; Laboratory findings; vital signs; 12-lead ECG., Incidences of ADAs against novel agent in serum., Serum concentrations of novel agent and derived PK parameters.

Source: https://euclinicaltrials.eu/ctis-public/view/2024-510977-27-00